EU clinical trial 2023-504601-36-00: An Extension Trial to Evaluate the Long-term Safety and Efficacy of Bimatoprost SR in Patients with Open Angle Glaucoma or Ocular Hypertension
Protocol code: 1698-302-007
Sponsor: AbbVie Deutschland GmbH & Co. KG (Pharmaceutical company). Phase: Therapeutic confirmatory (Phase III). Countries: Poland (ended), Germany (ended), France (ended), Spain (ended).
Therapeutic area(s): Diseases [C] - Eye Diseases [C11]
Gender: Female, Male. Age: 18-64 years, 65+ years. Enrolment: 28.
Status: Ended. Start date (EU): 2019-11-20. End date (EU): 2025-04-10. End date: 2026-06-19. Decision date: 2023-11-24. Results received: No. Last updated: 2025-04-15.
Decision dates by country: ES: 2023-11-24, FR: 2023-12-06, PL: 2023-11-26, DE: 2023-11-29

Condition(s): Open-angle Glaucoma, Ocular Hypertension
Product: Bimatoprost SR

Primary endpoint: AEs, visual field, visual acuity, macroscopic conjunctival hyperemia, slit-lamp biomicroscopic assessments, dilated ophthalmoscopic assessments (including optic disc assessment), contact ultrasound pachymetry, gonioscopy (implant assessment), and specular microscopy., Key endpoint: time from last Bimatoprost SR treatment in the lead-in study to first rescue treatment or first Bimatoprost SR PRN retreatment, Additional endpoints: time from SLT treatment in the lead-in study to first rescue treatment in the SLT-treated eye (Phase 3 study comparator) for patients from Study 192024-093 or -095

Source: https://euclinicaltrials.eu/ctis-public/view/2023-504601-36-00